EU clinical trial 2024-514964-24-00: FirST lines of biologics in pAtients with ulceRaTivE colitis: a Randomised controlled trial
Protocol code: PHRC N 2020 BUISSON
Sponsor: University Hospital Of Clermont-Ferrand (Hospital/Clinic/Other health care facility). Phase: Therapeutic confirmatory (Phase III). Countries: France (authorised, recruitment pending).
Therapeutic area(s): Diseases [C] - Digestive System Diseases [C06]
Gender: Female, Male. Age: 18-64 years. Enrolment: 240.
Status: Authorised, recruitment pending. Decision date: 2026-04-08. Results received: No. Last updated: 2026-04-08.

Condition(s): ulcerative colitis
Product: STEQEYMA 130 mg concentrate for solution for infusion, Remsima 100 mg powder for concentrate for solution for infusion, Jyseleca 200 mg film-coated tablets, Entyvio 300 mg powder for concentrate for solution for infusion

Primary endpoint: Remission (composite criteria) = no rectal bleeding, normalization of bowel habits (Mayo sub-score of stool frequency = 0) AND faecal calprotectin < 150 µg/g AND no steroids. Remission will be assessed as a binary criterion (yes/no) each month (i.e. 4 weeks-period) between week 4 and week 52, the month being considered as the statistical unit and not the patient.
Endpoint(s): 1) Remission within the first 24 months, 2) Absence of symptoms within the first 12 or within the first 24 months (= no rectal bleeding, normalization of bowel habits (Mayo sub-score of stool frequency = 0) and no steroids., 3) Biological remission (defined using levels of faecal calprotectin < 50 μg/g, < 150 μg/g, < 250 μg/g), 4) Endoscopic improvement (mayo endoscopic score (MES) ≤ 1) at W16, W52 and W104, 5) Endoscopic remission (MES = 0) at W16, W52 and W104, 6) Histological healing (Nancy index ≤ 1) at W16, W52 and W104, 7) Clinical remission (total Mayo score ≤ 2 without any subscore >1) at W16, W52 and W104, 8) Clinical remission (per Modified Mayo Score) is defined as stool frequency subscore (SFS) ≤1, rectal bleeding subscore (RBS) of 0 and endoscopic subscore ≤1at W16, W52 and W104, 9) Histo-endoscopical mucosal improvement (HEMI) (endoscopic improvement and histologic remission) at W16, W52 and W104, 10) Histo-endoscopical mucosal healing (HEMH) (endoscopic and histologic remission) at W16, W52 and W104, 11) Symptomatic remission (no rectal bleeding and normalization of bowel habits (SF Mayo sub-score ≤ 1) at each visit, 12) Level of faecal calprotectin at each visit, 13) Rate and number of days spent in clinical remission, 14) Acceptability of drug regimen (numerical scale from 0 to 10) at W8, W16, W24, W32, W42, W52, W76 and W104, 15) Time to drug failure, 16) Time to clinical response including each individual symptoms (rectal bleeding, bowel habits and urgency), 17) Partial Mayo score and simple clinical colitis activity index (SCCAI) at W8, W16, W24, W32, W42, W52, W76 and W104, 18) Rate and type of adverse events at W8, W16, W24, W32, W42, W52, W76 and W104, 19) Colectomy rate at W8, W16, W24, W32, W42, W52, W76 and W104, 20) Quality of life assessed by the IBD questionnaire at W8, W16, W24, W32, W42, W52, W76 and W104, 21) Disability assessed by IBD disability index at W8, W16, W24, W32, W42, W52, W76 and W104, 22) Disappearance of rectal bleeding, faecal urgency and normalization of bowel habits at W8, W16, W24, W32, W42, W52, W76 and W104.

Source: https://euclinicaltrials.eu/ctis-public/view/2024-514964-24-00